EU clinical trial 2024-516337-12-00: Multinational, multicentre, double-blind study to evaluate the efficacy and safety of bovine chondroitin sulfate 800 mg tablets versus marine chondroitin sulfate 800 mg tablets in the treatment of pain and functional impairment due to knee osteoarthritis
Protocol code: 23EU-Ct11
Sponsor: IBSA Institut Biochimique SA (Pharmaceutical company). Phase: Therapeutic confirmatory (Phase III). Countries: Czechia (ongoing, recruiting), Hungary (ongoing, recruiting), Poland (ongoing, recruiting).
Therapeutic area(s): Diseases [C] - Musculoskeletal Diseases [C05]
Gender: Female, Male. Age: 18-64 years, 65+ years. Enrolment: 520.
Status: Ongoing, recruiting. Start date (EU): 2025-08-07. Decision date: 2025-04-09. Results received: No. Last updated: 2026-02-23.
Decision dates by country: CZ: 2025-04-09, HU: 2025-04-10, PL: 2025-04-14

Condition(s): Knee osteoarthritis with moderate to severe pain
Product: CONDROSULF 800 mg tabletta

Primary endpoint: Change from Baseline to Week 24 in the weekly mean (7-day average) of the average daily pain in the target knee as measured by the NRS (0-10 points);, Change from Baseline to Week 24 in mean score of WOMAC® function subscale, as measured by the NRS (0-10 points).
Endpoint(s): Change from Baseline to each week until Week 24 in the weekly mean of the average daily pain in the target knee as measured with the NRS;, Change from Baseline to end of follow-up period (i.e. 12 weeks after the end of treatment) of the daily (24-hour) pain in the target knee as measured with the NRS;, Responder rates at each visit using 2 different response definitions (≥ 30% or ≥ 50% decrease versus Baseline in weekly mean of the average daily (24-hour) NRS pain intensity score);, Change from Baseline to Weeks 4, 12 and 24 in mean WOMAC® total score and all mean WOMAC® subscores (except for the primary endpoint change from Baseline to Week 24 in mean score of WOMAC® function subscale);, Change from Baseline to Weeks 4, 12 and 24 in patient’s quality of life (EQ-5D-5L);, Patient’s global evaluation at Weeks 4, 12, and 24 as measured by PGIC using a 5-point rating scale;, Investigator’s global evaluation at Weeks 4, 12 and 24 as measured by CGIC using a 5-point rating scale;, Consumption of rescue medication (paracetamol), including the number and proportion of users, the number of daily intakes and total dose per day.

Source: https://euclinicaltrials.eu/ctis-public/view/2024-516337-12-00